EU clinical trial 2026-526821-16-00: Melanoma-TBK1-inhibitor enhanced Immuno Therapy with Checkpoint Inhibitors: a Phase IB/II Trial in Unresectable Stage III or Stage IV Cutaneous Melanoma
Sponsor: Karolinska University Hospital (Hospital/Clinic/Other health care facility). Phase: Phase I and Phase II (Integrated)- Other. Countries: Sweden (authorised, recruitment pending).
Therapeutic area(s): Diseases [C] - Neoplasms [C04]
Gender: Female, Male. Age: 18-64 years, 65+ years. Enrolment: 105.
Status: Authorised, recruitment pending. Decision date: 2026-07-28. Results received: No. Last updated: 2026-07-28.

Condition(s): Unresectable Stage III or Stage IV Cutaneous Melanoma
Product: Omjjara 200 mg film-coated tablets, KEYTRUDA 25 mg/mL concentrate for solution for infusion., OPDIVO 10 mg/mL concentrate for solution for infusion., Omjjara 100 mg film-coated tablets, Omjjara 150 mg film-coated tablets

Primary endpoint: Phase Ib: Incidence and severity of TE(S)AEs, SAEs, AEs and clinically significant laboratory abnormalities and deaths according to the CTCAE v5.0 assessed continuously. In practice these will be assessed as per protocol or at each visit., Phase Ib: DLTs, MTD, and to establish the RP2D. The efficacy endpoints in Phase 1b will be summarized and listed by dose level based on the Safety Analysis Set., Phase II: ORR as of Month 6 (ORR(Month 6): CR + PR (CR(Month 6) + PR(Month 6)) of M + N/P using RECIST 1.1 and intention-to-treat (ITT). The primary efficacy analysis will be performed when all subjects have either completed 6 months of study treatment (corresponding to after 4-6-8-12 cycles of anti-PD-1 treatment based on the anti-PD-1 therapy schedule for nivolumab or pembrolizumab (section 7.1.1)), or discontinued due to disease progression, unacceptable toxicity, withdrawal of consent, or, Phase II: CR, PR, SD or progressive disease (PD) counts at the radiological response evaluations at 6 months from the first dose of the study treatment according to RECIST v1.1 and ITT.
Endpoint(s): Tolerability and safety profile of the study treatment combination, i.e. TEAEs, (S)AEs, according to CTCAE v5.0, and clinically significant laboratory abnormalities and deaths assessed at 6 months, 12 months, and then yearly during the active follow-up (FU) from the first dose of the study treatment of the last included patient. (Phase II)., AEs (all grades) according to the CTCAE v.5.0, during the treatment period., CR, PR, SD or PD counts at the response evaluations at 3 months, 6 months (Phase Ib only), and 12 months from the first dose of the study treatment as assessed by RECIST v1.1 and ITT., ORR based on the endpoints CR or PR according to RECIST v1.1 and ITT, at the radiological response evaluations at 3 months, 6 months (Phase Ib only), and 12 months from the first dose of the study treatment., Clinical benefit rate (CR+PR+SD) at 3 months, 6 months, and 12 months as timed from first dose of the study treatment., TTR, defined as time from first dose of the study treatment until the first documented OR according to RECIST v1.1., DoR, defined as the time from initial response (CR or PR) until the time of progression or death according to RECIST v1.1., OS, defined as the time from the first dose of the study treatment until death of any cause., PFS, defined as the time from the first dose of the study treatment until disease progression per RECIST v1.1 and/or death of any cause., MSS, defined as the time from the first dose of the study treatment until melanoma-progression or death from the disease., QoL measured according to QLQ-C30 at screening, and then yearly including during the active FU from the first dose of the study treatment (Phase II)., Pharmacodynamic analyses including RNA-sequencing (seq) of whole blood for differences in the expression of interferon-stimulated genes (ISG), interferon regulatory factor 3 (IRF3) phosphorylation and analyses of cytokine levels for evaluation of pharmacodynamics weekly during the first treatment cycles in Phase Ib., Correlation of different biological markers including but not limited to T cells, T-/B cell receptors (TCRs/BCRs), proteins, extra cellular vesicles (EVs), and circulating tumor DNA (ctDNA), analyzed from sequential blood and tumor samples with treatment efficacy and safety., To assess the role of SAMHD1 protein expression for the effect (i.e in relation to therapy response according to RECIST v1.1 and survival outcomes) of momelotinib added to standard melanoma therapy consisting of anti-PD-1 (i.e., nivolumab or pembrolizumab).

Source: https://euclinicaltrials.eu/ctis-public/view/2026-526821-16-00